EU clinical trial 2024-511219-78-00: MATAO MAintenance Therapy with Aromatase inhibitor in epithelial Ovarian cancer: a randomized double-blinded placebo-controlled multi-center phase III Trial (ENGOT-ov54/Swiss-GO-2/MATAO) including LOGOS (Low Grade Ovarian cancer Sub-study)
Protocol code: ENGOT-ov54/MATAO
Sponsor: Swiss GO Trial Group (Laboratory/Research/Testing facility). Phase: Therapeutic confirmatory (Phase III). Countries: Germany (ongoing, recruiting), Austria (ongoing, recruiting).
Therapeutic area(s): Diseases [C] - Female Urogenital Diseases and Pregnancy Complications [C13]
Gender: Female. Age: 18-64 years, 65+ years. Enrolment: 300.
Status: Ongoing, recruiting. Start date (EU): 2023-02-28. Decision date: 2024-08-23. Results received: No. Last updated: 2026-04-02.
Decision dates by country: AT: 2024-09-02, DE: 2024-08-23

Condition(s): epithelial ovarian cancer
Product: The matching placebo to FEM345 2.5 mg film-coated tablets is a mixture of inactive excipients compressed and coated to film-coated tablets matching those used for the drug product., LETROZOLE

Primary endpoint: The primary outcome is Progression-Free Survival (PFS), defined as the time from randomization until the date of progression (recurrence) or death by any cause in the absence of progression.
Endpoint(s): Overall Survival (OS), defined for each patient as the time from randomization until the date of death from any cause., Quality-Adjusted Progression Free Survival (QAPFS), defined as the time from randomization until the date of progression (recurrence) or death by any cause in the absence of progression under consideration of the quality of life during this period., Time until First Subsequent Therapy (TFST), defined for each patient as the time from randomization until the date the patient started the next (second line) subsequent anticancer treatment. Patients not receiving a subsequent anticancer treatment at the time of analysis will be censored at the date they were last known to be alive., Quality adjusted Time Without appearance of any Symptoms and Toxicity (Q-TWiST), related to either the progression of the cancer or side effects of the trial medication from randomization until death.

Source: https://euclinicaltrials.eu/ctis-public/view/2024-511219-78-00